EU clinical trial 2023-504571-25-00: A Study Evaluating the Safety and Pharmacokinetics of Escalating Doses of Forimtamig in Participants With Relapsed or Refractory Multiple Myeloma
Protocol code: BP42233
Sponsor: F. Hoffmann-La Roche AG (Pharmaceutical company). Phase: Human Pharmacology (Phase I)- Other. Countries: Spain (ended), Italy (ended), Denmark (ended), France (ended), Belgium (ended).
Therapeutic area(s): Diseases [C] - Neoplasms [C04]
Gender: Female, Male. Age: 18-64 years, 65+ years. Enrolment: 180.
Status: Ended. Start date (EU): 2020-10-20. End date (EU): 2026-03-13. End date: 2026-03-18. Decision date: 2024-03-15. Results received: No. Last updated: 2025-12-09.
Decision dates by country: DK: 2024-03-15, BE: 2024-03-28, FR: 2024-03-20, ES: 2024-03-19, IT: 2024-05-22

Condition(s): Relapsed or Refractory Multiple Myeloma

Source: https://euclinicaltrials.eu/ctis-public/view/2023-504571-25-00